EU clinical trial 2024-517321-99-00: A prospective phase II study to assess the minimal residual disease after ixazomib plus lenalidomide plus dexamethasone (IRd) treatment for newly diagnosed transplant eligible patients
Protocol code: IRd, NMSG#23/15
Sponsor: HUS-Yhtymae (Hospital/Clinic/Other health care facility). Phase: Therapeutic exploratory (Phase II). Countries: Finland (ongoing, recruitment ended), Sweden (ongoing, recruitment ended), Lithuania (ongoing, recruitment ended), Norway (ongoing, recruitment ended).
Therapeutic area(s): Diseases [C] - Hemic and Lymphatic Diseases [C15]
Gender: Female, Male. Age: 18-64 years, 65+ years. Enrolment: 120.
Status: Ongoing, recruitment ended. Start date (EU): 2016-08-01. Decision date: 2024-10-22. Results received: No. Last updated: 2024-11-04.
Decision dates by country: FI: 2024-10-22, LT: 2024-11-04, SE: 2024-10-24, NO: 2024-10-22

Condition(s): Myeloma multiplex
Product: Revlimid 10 mg hard capsules, Revlimid 15 mg hard capsules, Revlimid 20 mg hard capsules, IXAZOMIB, NINLARO 4 mg hard capsules, IXAZOMIB, Revlimid 25 mg hard capsules, Revlimid 5 mg hard capsules

Primary endpoint: To determine the proportion of patients with undetectable flow MRD with sensitivity of 10-5 at any time during protocol treatment.

Source: https://euclinicaltrials.eu/ctis-public/view/2024-517321-99-00